EU clinical trial 2025-524624-21-00: Application of radiomics in molecular imaging (18F-FDG-PET/CT) for diagnosis and follow-up of cardiovascular device infections: PREDICT study
Protocol code: PREDICT study
Sponsor: Fundacio De Recerca Clinic Barcelona-Institut D’Investigacions Biomediques August Pi I Sunyer (Laboratory/Research/Testing facility). Phase: Therapeutic use (Phase IV). Countries: Spain (authorised, recruitment pending).
Therapeutic area(s): Diseases [C] - Virus Diseases [C02]
Gender: Female, Male. Age: 18-64 years, 65+ years. Enrolment: 200.
Status: Authorised, recruitment pending. Decision date: 2026-04-07. Results received: No. Last updated: 2026-04-07.

Condition(s): Cardiovascular device infections
Product: Fludesoxiglucosa (18F)-Curium 185 MBq/ml, solución inyectable

Primary endpoint: Diagnostic accuracy of radiomics applied to FDG-PET for CVDIs, compared with conventional visual and semiquantitative interpretation.
Endpoint(s): Performance of AI-based predictive models (combining radiomic and clinical features) for: o Distinguishing infection vs. non-infection. o Predicting resolution of infection and supporting discontinuation of suppressive antimicrobial therapy., Characterization of physiological 18F-FDG uptake patterns in cardiovascular device carriers without infection, stratified by sex and time since implantation.

Source: https://euclinicaltrials.eu/ctis-public/view/2025-524624-21-00